EU clinical trial 2026-525181-22-00: ECETEP : Pilot study evaluating PSMA positron emission tomography for monitoring clinically significant prostate cancer after focal HIFU treatment
Sponsor: Centre Hospitalier Universitaire De Toulouse (Hospital/Clinic/Other health care facility). Phase: Therapeutic use (Phase IV). Countries: France (authorised, recruitment pending).
Therapeutic area(s): Analytical, Diagnostic and Therapeutic Techniques and Equipment [E] - Diagnosis [E01]; Diseases [C] - Male Urogenital Diseases [C12]
Gender: Male. Age: 65+ years. Enrolment: 30.
Status: Authorised, recruitment pending. Decision date: 2026-06-25. Results received: No. Last updated: 2026-06-25.

Condition(s): prostate cancer
Product: PIFLUFOLASTAT (18F)

Primary endpoint: presence of prostate cancer recurrence at 1-year follow-up detected by PSMA PET and confirmed by biopsies (gold standard).The sensitivity and specificity of PSMA PET will be estimated, as well as the positive predictive values.
Endpoint(s): presence of prostate cancer recurrence at 1-year follow-up detected by multiparametric MRI and confirmed by biopsies (gold standard), PSMA PET FALSE NEGATIVE RATE AT THE TIME OF DIAGNOSIS, ESTIMATION OF THE DIAGNOSTIC PERFORMANCE OF THE PRIMARY SCORE

Source: https://euclinicaltrials.eu/ctis-public/view/2026-525181-22-00